EU clinical trial 2024-510651-35-00: Diagnostic efficacy of 18F-FAPI-74 PET/CT in patients with colon cancer
Sponsor: Turku University Hospital (Hospital/Clinic/Other health care facility). Phase: Therapeutic exploratory (Phase II). Countries: Finland (ongoing, recruiting).
Therapeutic area(s): Diseases [C] - Neoplasms [C04]
Gender: Female, Male. Age: 18-64 years, 65+ years. Enrolment: 100.
Status: Ongoing, recruiting. Start date (EU): 2024-10-14. Decision date: 2024-08-20. Results received: No. Last updated: 2024-08-20.

Condition(s): Colon cancer
Product: [18F]FAPI-74

Primary endpoint: FAPI-74-PET/CT has a 70 % sensitivity in detecting metastathic lymph nodes

Source: https://euclinicaltrials.eu/ctis-public/view/2024-510651-35-00